EU clinical trial 2025-522146-40-00: A phase 2, multicenter, randomized, placebo-controlled, double-blind study to investigate the safety, pharmacodynamics, and preliminary efficacy of S-606001 as an add-on to enzyme replacement therapy in patients with late-onset Pompe disease.
Protocol code: 2405N1221
Sponsor: Shionogi B.V. (Pharmaceutical company). Phase: Therapeutic exploratory (Phase II). Countries: Belgium (ongoing, recruiting), Germany (ongoing, recruiting), Denmark (authorised, recruitment pending), France (ongoing, recruiting), Italy (ongoing, recruiting), Spain (ongoing, recruiting), Netherlands (authorised, recruiting).
Therapeutic area(s): Diseases [C] - Nutritional and Metabolic Diseases [C18]
Gender: Female, Male. Age: 18-64 years. Enrolment: 21.
Start date (EU): 2026-02-12. Decision date: 2025-12-01. Results received: No. Last updated: 2026-07-21.
Decision dates by country: BE: 2025-12-03, DK: 2025-12-01, FR: 2025-12-19, DE: 2025-12-01, IT: 2025-12-02, ES: 2026-01-30, NL: 2026-02-26

Condition(s): Late-onset Pompe disease.
Product: S-606001 matching placebo, S-606001

Primary endpoint: Change from baseline in %FVC at 52 weeks.
Endpoint(s): 1. Assessment of adverse events and treatment-emergent adverse events. Physical examinations and vital sign measurements. Clinical laboratory evaluations including biochemistry, hematology, and urinalysis. Electrocardiograms., 2. Plasma concentration of S-606001 and metabolites, 3. Change from baseline in the parameters stated in the protocol., 4. Change from baseline in 6-minute walk test., 5. Change from baseline in pulmonary function parameters: maximal inspiratory pressure and maximal expiratory pressure. Change from baseline in motor function parameters: Gait, Stair, Gower’s Maneuver, Chair (GSGC) score and Daily Living Activity Levels. Change from baseline in the following parameters: PROMIS-Fatigue-8a, PROMIS-Item Bank - PF20, PROMIS-Dyspnea, PROMIS v2.0 PAIN, SF-36 and PGI-S.

Source: https://euclinicaltrials.eu/ctis-public/view/2025-522146-40-00